EU clinical trial 2024-514930-19-00: A FIRST-IN-HUMAN (FIH) STUDY OF IDRX-42 IN PARTICIPANTS WITH METASTATIC AND/OR UNRESECTABLE GASTROINTESTINAL STROMAL TUMORS (GIST)
Protocol code: IDRX-42-001 (300382)
Sponsor: Idrx Inc. (Pharmaceutical company). Phase: Phase I and Phase II (Integrated)- Other. Countries: France (ongoing, recruitment ended), Spain (ongoing, recruitment ended), Netherlands (ongoing, recruitment ended), Germany (ongoing, recruitment ended), Belgium (ongoing, recruitment ended), Italy (ongoing, recruitment ended).
Therapeutic area(s): Diseases [C] - Neoplasms [C04]
Gender: Female, Male. Age: 18-64 years, 65+ years. Enrolment: 130.
Status: Ongoing, recruitment ended. Start date (EU): 2022-10-07. Decision date: 2024-08-05. Results received: No. Last updated: 2026-06-25.
Decision dates by country: FR: 2024-08-09, DE: 2024-08-20, ES: 2024-08-12, BE: 2024-08-06, IT: 2024-08-12, NL: 2024-08-05

Condition(s): metastatic and/or unresectable gastrointestinal stromal tumors (GIST)
Product: IDRX_20mg Capsule, IDRX_100 mg Capsule, tablets 100mg

Primary endpoint: Phase 1: Nature, incidence, and severity of treatment-emergent adverse events (TEAEs) and DLTs., Phase 1b: (1) Safety: Nature, incidence, and severity of TEAEs and change from baseline in laboratory results (2) Efficacy: ORR per Response Evaluation Criteria in Solid Tumors version 1.1 modified for participants with GIST (mRECIST v1.1, (Demetri 2013), Appendix C) per Independent Review (IR)Investigator assessment, C-QTc Sub-Study: QTcF – concentration response analysis
Endpoint(s): Phase1: (1) Nature, incidence, and severity of TEAEs and change from baseline in laboratory results., Phase 1: (2) PK parameters of IDRX-42, Phase 1: (3) Objective response rate (ORR) per Response Evaluation Criteria in Solid Tumors version 1.1 modified for participants with GIST (mRECIST v1.1, (Demetri 2013), Appendix C) per Investigator assessment, Phase 1: (4) Duration of response (DOR) per mRECIST v1.1 (Demetri 2013) per Investigator assessment, Phase 1: (5) Progression-free survival (PFS), per mRECIST v1.1 (Demetri 2013) per Investigator assessment, Phase 1: (6) Time to response (TTR) per mRECIST v1.1 (Demetri 2013) per Investigator assessment, Phase 1b: (7) DOR per mRECIST v1.1 (Demetri 2013) per Investigator assessment, Phase 1b: (8) PFS per mRECIST v1.1 (Demetri 2013) per Investigator assessment, Phase 1b: (9) Clinical benefit rate (CBR) per mRECIST v1.1 (Demetri 2013) per Investigator assessment, Phase 1b: (10) TTR per mRECIST v1.1 (Demetri 2013) per Investigator assessment, Phase 1b: (11) PK parameters of IDRX-42, Phase 1b: (12) Overall survival (OS), C-QTc Sub-Study: (1)QTcF (QT interval corrected by Fridericia's formula) at each post-dose time point and baseline (2)Change from baseline in the QTcF at each post-dose time point (3)Heart rate (HR), PR and QRS (QRS complex) interval at each post-dose time point and baseline (4)Change from baseline in HR, QRS, and PR-interval at each post-dose time point

Source: https://euclinicaltrials.eu/ctis-public/view/2024-514930-19-00